EU clinical trial 2022-502659-73-01: Repairing Peri-Anal Fistulas with regenerative cell therapeutics (REP-PAF)
Sponsor: Odense University Hospital (Hospital/Clinic/Other health care facility). Phase: Phase I and Phase II (Integrated)- First administration to humans. Countries: Denmark (ongoing, recruiting).
Therapeutic area(s): Diseases [C] - Digestive System Diseases [C06]
Gender: Female, Male. Age: 18-64 years, 65+ years. Enrolment: 75.
Status: Ongoing, recruiting. Start date (EU): 2024-10-09. Decision date: 2024-02-23. Results received: No. Last updated: 2026-06-12.

Condition(s): Crypto-glandular perianal fistula
Product: Adipose Derived Regenerative Cells ADRC/SVF, Culture expanded Adipose Derived Regenerative Cells, ADRC001

Primary endpoint: The healing rate (percentage) after observation time of six and twelve months. Clinical healing is defined as closure of the external opening(s), absence/cessation of discharge and swelling by palpation.
Endpoint(s): Functional outcome regarding quality of life and anal continence, measured by Short Form SF-36 Rand questionnaire and Wexner Fecal Incontinence score respectively, The risk factors for recurrence of PAF, The radiological healing, defined as no visible fistula or fluid collection more than 5 mm at MR imaging., A comparison of autologous vs. allogenic Adipose-Derived Regenerative Cells (ADRCs) regarding cell characterization, immune responses, and efficacy.

Source: https://euclinicaltrials.eu/ctis-public/view/2022-502659-73-01